EU clinical trial 2022-502386-13-00: A Phase 3 Open-label Study to Evaluate the Safety, Pharmacokinetics, Pharmacodynamics, and Efficacy of CSL312 (Garadacimab) in the Prophylactic Treatment of Hereditary Angioedema in Pediatric Subjects 2 to 11 Years of Age
Protocol code: CSL312_3003
Sponsor: CSL Behring LLC (Pharmaceutical company). Phase: Therapeutic confirmatory (Phase III). Countries: Germany (ended), Italy (ended).
Therapeutic area(s): Diseases [C] - Congenital, Hereditary, and Neonatal Diseases and Abnormalities [C16]
Gender: Female, Male. Age: 0-17 years. Enrolment: 7.
Status: Ended. Start date (EU): 2024-05-10. End date (EU): 2025-10-30. End date: 2025-11-19. Decision date: 2023-10-17. Results received: Yes. Last updated: 2025-10-29.
Decision dates by country: IT: 2023-10-20, DE: 2023-10-17

Condition(s): Hereditary angioedema (HAE)
Product: garadacimab

Primary endpoint: Number of subjects with treatment emergent adverse events (TEAEs), Percent of subjects with TEAEs, Number of TEAEs, TEAE rates per injection, TEAE rates per subject year, Maximum concentration (Cmax) of CSL312 at steady-state, Trough concentration (Ctrough) of CSL312 at steady-state, Time to maximum concentration (Tmax) of CSL312 at steady-state
Endpoint(s): Time-normalized number of HAE attacks per month and per year, Time-normalized number of HAE attacks treated with on-demand treatment per month and per year, Time-normalized number of moderate and / or severe HAE attacks per month and per year, Percentage reduction in the time-normalized number of HAE attacks, The number of subjects experiencing at least ≥ 50%, ≥ 70%, ≥ 90%, or equal to 100% (attack-free) reduction in the time-normalized number of HAE attacks, Number of subjects with serious adverse events (SAEs), Percent of subjects with SAEs, Number of subjects experiencing death, Percent of subjects experiencing death, Number of subjects with related TEAEs, Percent of subjects with related TEAEs, Number of subjects with TEAEs leading to study discontinuation, Percent of subjects with TEAEs leading to study discontinuation, Number of subjects with TEAEs by severity, Percent of subjects with TEAEs by severity, Number of subjects with Anti-CSL312 antibodies, Percent of subjects with Anti-CSL312 antibodies, Number of subjects with adverse events of special interest (AESIs), Percent of subjects with AESIs, FXIIa-mediated kallikrein activity, Number of subjects with laboratory findings reported as AEs, Percent of subjects with laboratory findings reported as AEs

Source: https://euclinicaltrials.eu/ctis-public/view/2022-502386-13-00